EU clinical trial 2023-506550-20-00: FDG-PET/CT versus conventional CT for response monitoring in metastatic breast cancer: A pilot study for a randomized clinical trial (MONITOR-PILOT)
Sponsor: Odense University Hospital (Hospital/Clinic/Other health care facility). Phase: Phase II and Phase III (Integrated). Countries: Denmark (ended).
Therapeutic area(s): Analytical, Diagnostic and Therapeutic Techniques and Equipment [E] - Diagnosis [E01]; Diseases [C] - Neoplasms [C04]
Gender: Female, Male. Age: 18-64 years, 65+ years. Enrolment: 30.
Status: Ended. Start date (EU): 2024-07-05. End date (EU): 2025-10-30. Decision date: 2024-03-25. Results received: No. Last updated: 2025-06-13.

Condition(s): Metastatic breast cancer
Product: FLUDEOXYGLUCOSE (18F)

Primary endpoint: Overall survival
Endpoint(s): Quality of life, Time and exposure to treatment, Cost-effectiveness, Occurrence of adverse events

Source: https://euclinicaltrials.eu/ctis-public/view/2023-506550-20-00